EU clinical trial 2024-513377-51-00: A clinical study of MK-2828 in healthy people (MK-2828-001)
Protocol code: MK-2828-001
Sponsor: Merck Sharp & Dohme LLC (Pharmaceutical company). Phase: Human Pharmacology (Phase I)- First administration to humans. Countries: Belgium (ended).
Therapeutic area(s): Diseases [C] - Cardiovascular Diseases [C14]
Gender: Male. Age: 18-64 years. Enrolment: 16.
Status: Ended. Start date (EU): 2024-08-01. End date (EU): 2024-11-25. End date: 2024-11-26. Decision date: 2024-07-19. Results received: No. Last updated: 2024-10-11.

Condition(s): Atherosclerosis

Source: https://euclinicaltrials.eu/ctis-public/view/2024-513377-51-00